EU clinical trial 2024-511404-17-00: A RANDOMIZED, OPEN-LABEL PHASE 3 STUDY IN PATIENTS WITH PREVIOUSLY TREATED UNRESECTABLE OR METASTATIC NRAS MUTANT CUTANEOUS MELANOMA COMPARING THE COMBINATION OF NAPORAFENIB + TRAMETINIB TO PHYSICIAN’S CHOICE OF THERAPY (DACARBAZINE, TEMOZOLOMIDE OR TRAMETINIB MONOTHERAPY) WITH A DOSE OPTIMIZATION LEAD-IN [SEACRAFT-2]
Protocol code: ERAS-254-02
Sponsor: Erasca Inc. (Pharmaceutical company). Phase: Therapeutic confirmatory (Phase III). Countries: Czechia (ended), Sweden (ended), France (ended), Spain (ended), Belgium (ended), Netherlands (ended), Denmark (ended), Italy (ongoing, recruitment ended), Norway (ended), Germany (ended).
Therapeutic area(s): Diseases [C] - Neoplasms [C04]
Gender: Female, Male. Age: 18-64 years, 65+ years. Enrolment: 294.
Start date (EU): 2024-10-07. Decision date: 2024-09-16. Results received: No. Last updated: 2026-02-02.
Decision dates by country: BE: 2024-09-17, DK: 2024-09-16, SE: 2024-09-16, NO: 2024-09-19, NL: 2024-09-16, ES: 2024-09-16, CZ: 2024-09-17, IT: 2024-09-18, DE: 2024-09-18, FR: 2024-09-20

Condition(s): Unresectable or metastatic NRAS mutant cutaneous melanoma
Product: Temomedac 20 mg hard capsules, Dacarbazine medac 1000 mg, powder for solution for infusion, Mekinist 0.5 mg film-coated tablets, Temomedac 20 mg hard capsules, Naporafenib 200mg, Hydrocortisone 1 % w/w Cream, Dacarbazine medac 500 mg, powder for solution for infusion, Naporafenib 100 mg, Dacarbazine medac 200 mg, powder for solution for injection/infusion, Temomedac 100 mg hard capsules, Dacarbazine medac 100 mg, powder for solution for injection/infusion, Temomedac 100 mg hard capsules, Doxy-M-ratiopharm® 100 mg Tabletten, Naporafenib 50mg, Mekinist 0.5 mg film-coated tablets, Naporafenib 75 mg

Primary endpoint: Stage 1 (Dose Optimization) - Analysis of the totality of the safety, pharmacokinetics (PK), and preliminary efficacy data including exposure response relationships for tolerability, safety, and efficacy from Stage 1 and throughout the naporafenib program, Stage 2 (Registration-Enabling Portion) - PFS using RECIST v1.1 per blinded independent central review (BICR), Stage 2 (Registration-Enabling Portion) - OS
Endpoint(s): Stage 1 (Dose Optimization) - Using Response Evaluation Criteria in Solid Tumors (RECIST) v1.1: • Objective response rate (ORR) • Disease control rate (DCR) • Duration of response (DOR) • Progression-free survival (PFS) • Time to response (TTR), Stage 1 (Dose Optimization) - Safety: incidence and severity of adverse events (AE) and serious adverse events (SAE), changes from baseline in laboratory values, vital signs, and cardiac assessments (electrocardiogram [ECG], echocardiogram [ECHO]/multigated acquisition [MUGA]) Tolerability: AEs leading to dose interruptions, reductions, and permanent discontinuation of study drug(s), Stage 1 (Dose Optimization) - Plasma concentrations of naporafenib and trametinib as combination therapy and plasma concentrations of trametinib as monotherapy obtained via sparse sampling for population PK modeling, Stage 2 (Registration-Enabling Portion) - Using RECIST v1.1, per BICR: • ORR • DOR, Stage 2 (Registration-Enabling Portion) - Safety: Incidence and severity of AEs and SAEs, changes from baseline in laboratory values, vital signs, and cardiac assessments (ECG, ECHO/ MUGA) Tolerability: AEs leading to dose interruptions, reductions, and permanent discontinuation of study drug(s), Stage 2 (Registration-Enabling Portion) - Using RECIST v1.1, per investigator assessment: • PFS • ORR • DOR • DCR • TTR, Stage 2 (Registration-Enabling Portion) - Plasma concentrations of naporafenib and trametinib as combination therapy obtained via sparse sampling for population PK modeling, Stage 2 (Registration-Enabling Portion) - Change from baseline in: • EORTC QLQ-C30 subscales • PRO CTCAE® symptoms Change from baseline to landmark timepoint(s) for one or more of the above measures; specific endpoints of interest will be selected based on data from Stage 1 and prespecified before initiating Stage 2.

Source: https://euclinicaltrials.eu/ctis-public/view/2024-511404-17-00